EU clinical trial 2024-516612-16-00: A Phase II trial aiming to assess the safety and activity of the combination of cabozantinib plus lanreotide in gastroenteropancreatic (GEP) and thoracic neuroendocrine tumor (NET): The LOLA trial
Protocol code: LOLA trial
Sponsor: Fondazione IRCCS Istituto Nazionale Dei Tumori (Hospital/Clinic/Other health care facility). Phase: Therapeutic exploratory (Phase II). Countries: Italy (ongoing, recruiting).
Therapeutic area(s): Diseases [C] - Neoplasms [C04]
Gender: Female, Male. Age: 18-64 years, 65+ years. Enrolment: 69.
Status: Ongoing, recruiting. Start date (EU): 2020-06-17. Decision date: 2024-11-04. Results received: No. Last updated: 2024-11-04.

Condition(s): gastroenteropancreatic (GEP) and thoracic neuroendocrine tumor (NET)
Product: CABOZANTINIB, CABOZANTINIB, LANREOTIDE, CABOZANTINIB

Primary endpoint: Safety and tolerabilitity in terms of the rate (%) of patients experiencing grade 3-5 toxicities according to National Cancer Institute-Common Terminology Criteria for Adverse Events (NCI-CTCAE) version 5.0
Endpoint(s): Secondary endpoints include Progression Free Survival (PFS) and Overall Survival (OS)

Source: https://euclinicaltrials.eu/ctis-public/view/2024-516612-16-00